EU clinical trial 2025-520678-20-00: Topical Clobetasol Propionate for Inflammatory Hand osteoarthritis: A randomized trial versus placebo.(PROCLAME)
Protocol code: APHP240804
Sponsor: Assistance Publique Hopitaux De Paris (Hospital/Clinic/Other health care facility). Phase: Therapeutic confirmatory (Phase III). Countries: France (authorised, recruitment pending).
Therapeutic area(s): Diseases [C] - Musculoskeletal Diseases [C05]
Gender: Female, Male. Age: 18-64 years, 65+ years. Enrolment: 187.
Status: Authorised, recruitment pending. Decision date: 2026-08-07. Results received: No. Last updated: 2026-08-07.

Condition(s): Adult patients with symptomatic and inflammatory Hand osteoarthritis HOA.
Product: Placebo de formule développée spécifiquement pour la recherche par la PUI (cf IMPD-Q), CLOBETASOL PROPIONATE

Primary endpoint: The primary endpoint is the change in pain intensity between W0 and W4 (W4-W0). Self-reported hand pain in the previous 48h measured on a 100 mm VAS at W0 and W4. The measurement will be done with the standard question recommended by Osteoarthritis Research Society International (OARSI): “how much pain in your hands did you experience during the last 48h?”.
Endpoint(s): 1.Hand Pain improvement: -Change in pain intensity between W0 and W4 (W4-W0) of AUSCAN pain subscore 2.Hand function and stiffness improvement Change between W0 and W4 (W4-W0) in the following endpoints 3. Treatment response at W4 -Proportion of patients’ responders according to the Patient global impression of change (PGIC) 4.Quality of life improvement -Change between W0 and W4 (W4-W0) in: EQ-5D-5L index score, EQ-5D-5L Global health status

Source: https://euclinicaltrials.eu/ctis-public/view/2025-520678-20-00